EU clinical trial 2024-510867-42-00: Prospective randomised study of the impact of preoperative administration of mitomycin-C by electromotive drug administration (EMDA) in patients with non-muscle invasive urothelial carcinoma
Protocol code: URO-EMDA-2022-1
Sponsor: Fundacion Para El Fomento De La Investigacion Sanitaria Y Biomedica De La Comunitat Valenciana (Patient organisation/association). Phase: Therapeutic use (Phase IV). Countries: Spain (ongoing, recruiting).
Therapeutic area(s): Diseases [C] - Neoplasms [C04]
Gender: Female, Male. Age: 18-64 years, 65+ years. Enrolment: 228.
Status: Ongoing, recruiting. Start date (EU): 2023-04-24. Decision date: 2024-10-25. Results received: No. Last updated: 2024-10-25.

Condition(s): non-muscle invasive bladder tumors
Product: MITOMYCIN

Primary endpoint: Recurrence free survival, Progresion free survival
Endpoint(s): Total cases of adverse effects by group, Therapeutic completion rate by group, Impact of recurrence free survival and progresion free survival depending on inflammatory response parameters

Source: https://euclinicaltrials.eu/ctis-public/view/2024-510867-42-00